EU clinical trial 2022-502135-19-00: A randomized double-blind, placebo-controlled, multicenter trial assessing the impact of lipoprotein(a) lowering with pelacarsen (TQJ230) on the progression of calcific aortic valve stenosis [Lp(a)FRONTIERS CAVS]
Protocol code: CTQJ230A12203
Sponsor: Novartis Pharma AG (Pharmaceutical company). Phase: Therapeutic exploratory (Phase II). Countries: Denmark (ongoing, recruiting), Italy (ongoing, recruiting), Netherlands (ongoing, recruiting), Portugal (ongoing, recruiting), Czechia (ongoing, recruiting), Austria (ongoing, recruiting), Germany (ongoing, recruiting), Belgium (ongoing, recruiting), France (ongoing, recruiting), Spain (ongoing, recruiting).
Therapeutic area(s): Diseases [C] - Cardiovascular Diseases [C14]
Gender: Female, Male. Age: 18-64 years, 65+ years. Enrolment: 239.
Status: Ongoing, recruiting. Start date (EU): 2024-07-18. Decision date: 2024-05-24. Results received: No. Last updated: 2026-08-07.
Decision dates by country: AT: 2024-05-29, ES: 2024-05-28, CZ: 2024-05-27, FR: 2024-05-28, IT: 2024-05-29, PT: 2024-05-28, NL: 2024-05-29, DE: 2024-05-27, DK: 2024-05-24, BE: 2024-05-27

Condition(s): Calcific Aortic Valve Stenosis
Product: Placebo to TQJ230 80 mg/0.8 mL Solution for injection in pre-filled syringe with needle safety device, TQJ230

Primary endpoint: Change in peak aortic jet velocity from baseline to month 36, Change in aortic valve calcium score from baseline to month 36
Endpoint(s): Change in lipoprotein(a) levels from baseline to month 12, Change in fibrocalcific thickening of the aortic valve from baseline to month 36, Time from randomization to first occurrence of composite clinical endpoint event, defined as reaching either: • Unplanned CAVS related hospital admission • Aortic valve intervention • Death related to calcific aortic valve stenosis, Safety endpoints (including adverse events/serious adverse events, safety laboratory parameters, vital signs) collected from baseline to end of study

Source: https://euclinicaltrials.eu/ctis-public/view/2022-502135-19-00